EU clinical trial 2023-503368-18-00: A study to learn how safe the study treatment BAY2701250 is, how it affects the body and how it moves into, through and out of the body in healthy male participants when a single amount is given as an injection into the vein (intravenous infusion) or under the skin (subcutaneous injection).
Protocol code: 20799
Sponsor: Bayer AG (Pharmaceutical company). Phase: Human Pharmacology (Phase I)- First administration to humans. Countries: Germany (ended).
Therapeutic area(s): Diseases [C] - Cardiovascular Diseases [C14]
Gender: Male. Age: 18-64 years. Enrolment: 91.
Status: Ended. Start date (EU): 2023-09-14. End date (EU): 2025-05-20. Decision date: 2023-07-21. Results received: No. Last updated: 2024-12-13.

Condition(s): Pulmonary hypertension due to left heart disease

Source: https://euclinicaltrials.eu/ctis-public/view/2023-503368-18-00